EU clinical trial 2024-516929-31-00: Use of LOncastuximab Tesirine in patients with RElapsed/Refractory Diffuse Large B-Cell LYmphoma (DLBCL) or High Grade B-Cell Lymphoma (HGBCL) who have progressive disease after CAR T-cell treatment - LORELY
Protocol code: LORELY
Sponsor: Humanitas Mirasole S.p.A. (Hospital/Clinic/Other health care facility). Phase: Therapeutic exploratory (Phase II). Countries: Italy (ongoing, recruitment ended).
Therapeutic area(s): Diseases [C] - Hemic and Lymphatic Diseases [C15]
Gender: Female, Male. Age: 18-64 years, 65+ years. Enrolment: 50.
Status: Ongoing, recruitment ended. Start date (EU): 2023-06-19. Decision date: 2024-10-21. Results received: No. Last updated: 2026-01-16.

Condition(s): Patients affected by relapsed/refractory DLBCL or HGBCL failing CAR T-cell therapy
Product: Zynlonta 10 mg powder for concentrate for solution for infusion

Primary endpoint: Overall response rate (ORR) defined as patients in achieving a best overall response of complete response (CR) or partial response (PR) to study treatment, according to the 2014 Lugano Classification
Endpoint(s): • Progression-free survival (PFS) defined as the time between first dose administration and the first documentation of recurrence or progression by independent central review, or death • Overall survival (OS) defined as the time between first dose administration and death from any cause • Duration of Response (DOR) defined as the time from first documentation of response to recurrence or progression by independent central review, or death, • Frequency and severity of adverse events (AEs) and severeserious adverse events (SAEs), Exploratory • Relationship between blood serum markers of disease and inflammation (LDH, CRP, ferritin) and selected efficacy endpoints • Relationship between changes in plasma ctDNA and selected efficacy endpoints

Source: https://euclinicaltrials.eu/ctis-public/view/2024-516929-31-00